EU clinical trial 2023-506049-52-00: A phase II trial investigating MOsunetuzumab and ZAnubrutinib (BGB-3111) in Relapsed/refracTory follicular lymphoma patients (MOZART)
Protocol code: FIL_MOZART
Sponsor: Fondazione Italiana Linfomi Ets (Patient organisation/association). Phase: Therapeutic exploratory (Phase II). Countries: Italy (ongoing, recruitment ended).
Therapeutic area(s): Diseases [C] - Hemic and Lymphatic Diseases [C15]
Gender: Female, Male. Age: 18-64 years, 65+ years. Enrolment: 40.
Status: Ongoing, recruitment ended. Start date (EU): 2024-10-28. Decision date: 2024-10-02. Results received: No. Last updated: 2026-05-15.

Condition(s): Follicular lymphoma
Product: Mosunetuzumab, Mosunetuzumab, TOCILIZUMAB, BRUKINSA 80 mg hard capsules

Primary endpoint: CR rate (CRR) at the end of the combination therapy (according to Lugano, 2014 criteria).
Endpoint(s): ORR, PR rate at the end of the combination therapy (according to Lugano, 2014 criteria)., PFS defined as the time between the start of prephase and the first documentation of recurrence, progression or death for any cause., OS defined as the time between the start of prephase and death from any cause., DOR defined as the time from the first documentation of tumor response to disease progression or death from any cause., DOCR defined as the time from the first documentation of tumor complete response to disease progression or death from any cause., TTNT defined as the time between the start of the prephase and the initiation of the next line of therapy., EFS defined as the time from the start of the prephase to disease progression, death, or discontinuation of treatment for any reason (e.g. toxicity, patient preference, or initiation, of a new treatment without documented progression)., Frequency and severity of AEs and SAEs classified as per latest version of CTCAE., Frequency and severity of cytokine release syndrome (CRS) and Neurological Adverse Events (NAE) will be evaluated according the ASTCT Grading Criteria.

Source: https://euclinicaltrials.eu/ctis-public/view/2023-506049-52-00